EU clinical trial 2024-514808-13-00: Randomised phase 3 trial of enzalutamide in androgen deprivation therapy with radiation therapy for high risk, clinically localised, prostate cancer: ENZARAD
Sponsor: Cancer Trials Ireland (Patient organisation/association). Phase: Therapeutic confirmatory (Phase III). Countries: Austria (ended), Ireland (ended), Spain (ended).
Therapeutic area(s): Diseases [C] - Neoplasms [C04]
Gender: Male. Age: 18-64 years, 65+ years. Enrolment: 79.
Status: Ended. Start date (EU): 2015-03-06. End date (EU): 2025-10-03. Decision date: 2024-09-24. Results received: No. Last updated: 2026-01-23.
Decision dates by country: ES: 2024-10-08, AT: 2024-09-29, IE: 2024-09-24

Condition(s): Localised prostate cancer at high risk of recurrence
Product: Casodex® 50 mg Film-coated Tablets, ANANDRON 150 mg, comprimé, Flutamide 250 mg Tablets, Xtandi - 40 mg soft capsules

Primary endpoint: Metastasis-free survival (metastasis or death from any cause, MFS)
Endpoint(s): Overall survival (death from any cause, OS), Prostate cancer specific survival (death from prostate cancer), PSA progression-free survival (Phoenix criteria, or death from any cause, PSA-PFS), Clinical progression-free survival (imaging, symptoms, signs, initiation of other anti-cancer treatment, or death from any cause, clinical-PFS), Time to subsequent hormonal therapy (restarting ADT), Time to castration-resistant disease (PCWG2 criteria), Safety (adverse events - CTCAE v4.03), Health related quality of life (EORTC QLQC-30 & PR-25, EQ-5D-5L), Health outcomes relative to costs (incremental cost effectiveness ration)

Source: https://euclinicaltrials.eu/ctis-public/view/2024-514808-13-00